EU clinical trial 2025-522108-26-00: PRODIGE 115 (FFCD 2406) ULYSSE : A phase II, open-label, non-comparative, randomized study of second-line doublet chemotherapy (FOLFOX or FOLFIRI) plus Fruquintinib versus doublet chemotherapy (FOLFOX or FOLFIRI) plus Bevacizumab in metastatic colorectal cancer
Sponsor: Fondation Franc.Cancerologie Digestive (Hospital/Clinic/Other health care facility). Phase: Therapeutic exploratory (Phase II). Countries: France (ongoing, recruiting).
Therapeutic area(s): Diseases [C] - Digestive System Diseases [C06]
Gender: Female, Male. Age: 18-64 years, 65+ years. Enrolment: 74.
Status: Ongoing, recruiting. Start date (EU): 2026-02-19. Decision date: 2025-10-08. Results received: No. Last updated: 2025-10-08.

Condition(s): métastatique colorectal cancer
Product: FRUZAQLA 5 mg hard capsules, FLUOROURACIL, FOLINIC ACID, FLUOROURACIL, IRINOTECAN, OXALIPLATIN, Avastin 25 mg/ml concentrate for solution for infusion., FRUZAQLA 1 mg hard capsules

Primary endpoint: Disease Control Rate (DCR): defined as the percentage of patients with a complete response, a partial response or a stable disease at 4 months after the start of treatment.
Endpoint(s): Tolerability and safety will be assessed according to V5.0 of the National Cancer Institute Common Terminology Criteria for Adverse Events (NCI-CTCAE). Adverse events will be recorded up to 30 days after the last dose of treatment. Treatment duration, administered doses, dose intensity, dose modifications, treatment delays and the reason for definitive treatment discontinuation will also be evaluated, Progression Free Survival (PFS) will be defined as the time between the start of treatment and the date of the first radiological progression (according to RECIST v1.1 criteria assessed by the investigator) or death (whatever the cause), whichever occurs first. Patients alive without progression will be censored at the date of the last available CT-scan., Objective Response Rate (ORR) will be evaluated throughout the treatment, based on imaging and according to RECIST v1.1 criteria. The objective response rate is defined as the percentage of patients with a complete response or a partial response., Duration Of Response (DOR) will be defined as the time between the first complete or partial response and the date of radiological progression or death, whichever comes first., Overall Survival (OS) will be defined by the time between the start of treatment and the date of death (whatever the cause). Alive patients will be censored at the date of their last news., Quality of life: will be assessed with the EORTC QLQ-C30 questionnaire. The questionnaire is completed before the treatment starts, and during the study every 2 months. Time to definitive deterioration of the global health score will also be made. It’s defined as the time from the start of treatment to the date of death or the date of more than 5 points decrease compared to baseline score. Patients alive without degradation will be censored at the date of last questionnaire available., Time to WHO performance status (ps) degradation >2 will be collected at baseline and before each cure. Time to WHO ps degradation >2 is defined as the time from the start of treatment to the date of the first WHO ps >2 during the treatment period. Alive patients who are still under treatment with a WHO ps ≤ 2 will be censored at the date of the last available WHO ps value. Death will be considered as a WHO=5 so considered as an event.

Source: https://euclinicaltrials.eu/ctis-public/view/2025-522108-26-00